EU clinical trial 2025-521814-25-01: Study of exposure to substances prohibited by the World Anti-Doping Agency in healthy volunteers (ESPAMA_4). Proof of concept
Protocol code: IMIMFTCL/ESPAMA_4
Sponsor: Consorci Mar Parc De Salut De Barcelona (Hospital/Clinic/Other health care facility). Phase: Human Pharmacology (Phase I)- Other. Countries: Spain (ongoing, recruiting).
Therapeutic area(s): Not possible to specify
Gender: Male. Age: 18-64 years. Enrolment: 7.
Status: Ongoing, recruiting. Start date (EU): 2026-02-11. Decision date: 2025-08-06. Results received: No. Last updated: 2025-11-28.

Condition(s): Healthy volunteers

Source: https://euclinicaltrials.eu/ctis-public/view/2025-521814-25-01